EU clinical trial 2025-522100-25-00: A clinical study of MK-4082 in healthy people (MK-4082-001)
Protocol code: MK-4082-001
Sponsor: Merck Sharp & Dohme LLC (Pharmaceutical company). Phase: Human Pharmacology (Phase I)- First administration to humans. Countries: Belgium (ended).
Therapeutic area(s): Diseases [C] - Nutritional and Metabolic Diseases [C18]
Gender: Male. Age: 18-64 years. Enrolment: 64.
Status: Ended. Start date (EU): 2025-10-09. End date (EU): 2026-05-08. End date: 2026-05-09. Decision date: 2025-10-08. Results received: No. Last updated: 2026-02-12.

Condition(s): Weight management

Source: https://euclinicaltrials.eu/ctis-public/view/2025-522100-25-00